EU clinical trial 2024-512992-11-00: PET study of changes in [11C]AZ14132516 uptake following administration of multiple AZD7798 doses to patients with Crohn’s disease.
Protocol code: D9690C00007
Sponsor: AstraZeneca AB (Pharmaceutical company). Phase: Human Pharmacology (Phase I)- Other. Countries: Sweden (ended).
Therapeutic area(s): Diseases [C] - Digestive System Diseases [C06]
Gender: Female, Male. Age: 18-64 years, 65+ years. Enrolment: 12.
Status: Ended. Start date (EU): 2024-08-30. End date (EU): 2026-03-27. Decision date: 2024-07-25. Results received: No. Last updated: 2025-09-26.

Condition(s): Crohn's disease

Source: https://euclinicaltrials.eu/ctis-public/view/2024-512992-11-00